EU clinical trial 2024-512082-14-00: Short-term Pre-OPerative Durvalumab (MEDI 4736) in early small triple negative breast cancer patients (POP-Durva)
Protocol code: CSET n° 2020/3210
Sponsor: Institut Gustave Roussy (Hospital/Clinic/Other health care facility). Phase: Therapeutic exploratory (Phase II). Countries: France (ended).
Therapeutic area(s): Diseases [C] - Pathological Conditions, Signs and Symptoms [C23]; Diseases [C] - Immune System Diseases [C20]
Gender: Female. Age: 18-64 years, 65+ years. Enrolment: 100.
Status: Ended. Start date (EU): 2021-12-06. End date (EU): 2026-07-23. Decision date: 2024-04-26. Results received: No. Last updated: 2026-06-15.

Condition(s): Untreated small triple negative breast cancer

Source: https://euclinicaltrials.eu/ctis-public/view/2024-512082-14-00